EU clinical trial 2022-501086-41-00: Long-Term Follow-Up (LTFU) for Gene Therapy of Leukocyte Adhesion Deficiency-I (LAD-I). Phase I/II clinical study to evaluate the safety and efficacy of the infusion of autologous hematopoietic stem cells transduced with a lentiviral vector encoding the ITGB2 gene
Protocol code: RP-L201-0121-LTFU
Sponsor: Rocket Pharmaceuticals Inc. (Pharmaceutical company). Phase: Phase I and Phase II (Integrated)- Other. Countries: Spain (ongoing, recruitment ended).
Therapeutic area(s): Diseases [C] - Congenital, Hereditary, and Neonatal Diseases and Abnormalities [C16]
Gender: Female, Male. Age: 0-17 years, 18-64 years. Enrolment: 1.
Status: Ongoing, recruitment ended. Start date (EU): 2023-09-15. Decision date: 2023-07-06. Results received: No. Last updated: 2025-06-16.

Condition(s): Leukocyte Adhesion Deficiency-I (LAD-I)
Product: LADICell

Primary endpoint: Any significant infection, defined as those requiring hospitalization or intravenous antimicrobials, Any new skin or oral lesion potentially caused by underlying LAD-I disease., Any late-occurring (more than 2 years post-infusion) SAE considered at least possibly related to the investigational RP-L201 study treatment., Incidence of any malignancy, Any new incidence of secondary graft failure defined as a sustained decrease in PBMC VCN of <0.1 or PB neutrophil CD18 expression of <10% on 2 consecutive evaluations separated by an interval of at least 1 month, and not considered related to a concurrent infection or due to non-RP-L201 drug-related toxicity., Any new concerns for GvHD based on GVHD clinical classifications defined, Allogeneic HSCT-free survival;, Event free survival defined as survival in the absence of graft failure or GvHD;, Reduction of significant infections, defined as those requiring hospitalization or intravenous antimicrobials, Reduction of infection-related hospitalizations, and infection-related prolonged hospitalization (lasting ≥7 days) beyond the initial 24 months of RP-L201-0318;, Improvement or resolution of LAD-I-related neutrophilia and leukocytosis, Resolution of LAD-I-related skin rash or periodontal abnormalities;, Persistence of transgene in PB cells as demonstrated by VCN of at least 0.1 in PBMCs and PB CD15+ granulocytes;, Persistence of CD18 neutrophil expression defined by PB neutrophil CD18 expression to at least 10% of normal;, Persistence of CD11 a/b neutrophil co-expression.

Source: https://euclinicaltrials.eu/ctis-public/view/2022-501086-41-00